EU clinical trial 2024-517953-28-00: An open-label, randomized, non-comparative multi-center phase I/II study to assess the safety and the efficacy of SMART101 after HLA-mismatched peripheral blood stem cell transplantation with post-transplant cyclophosphamide in patients with hematological malignancies
Protocol code: SI101-02
Sponsor: Smart Immune (Pharmaceutical company). Phase: Phase I and Phase II (Integrated)- First administration to humans. Countries: Italy (ongoing, recruiting), France (ongoing, recruiting).
Therapeutic area(s): Diseases [C] - Neoplasms [C04]; Diseases [C] - Immune System Diseases [C20]
Gender: Female, Male. Age: 18-64 years, 65+ years. Enrolment: 39.
Status: Ongoing, recruiting. Start date (EU): 2023-06-07. Decision date: 2024-11-29. Results received: No. Last updated: 2025-04-03.
Decision dates by country: IT: 2024-12-03, FR: 2024-11-29

Condition(s): Treatment in haematopoietic stem cell transplantation
Product: SMART101

Primary endpoint: Safety (Segment 1 and Segment 2): Occurrence of Unexpected Unacceptable Toxicities (UUT) following the administration of SMART101, within 28 days post SMART101 infusion, Efficacy (Segment 2): T-cell reconstitution rate, defined as naïve CD4+ T cell count ≥ 50/μL within 100 days post-HSCT, confirmed on a subsequent measurement within 2 months
Endpoint(s): Occurrence of all adverse events (AEs) and serious adverse events (SAEs), and specifically the occurrence of Adverse Event of Special Interest (AESI) related to the HSCT procedure following the administration of SMART101, defined as: Grade III-IV acute GvHD; Graft failure, T-cell reconstitution defined as the assessment of the different CD3+ TCRαβ+ cell subpopulations at D30, D60, D100, M4, M5, M6, M9 and M12: Naïve CD4+ and CD8+ populations; Memory T cells within the CD4 and CD8 T cell compartments; Activated T cells within the CD4 and CD8 T cell compartments; Regulatory T cells, B-cell reconstitution defined as the following parameters at D30, D60, D100, M4, M5, M6, M9 and M12: Number of B cells; Ig levels; Stop of intravenously IgG replacement therapy, NK cell reconstitution at D30, D60, D100, M4, M5, M6, M9 and M12, Analysis of the recent thymic emigrant (RTE) at D30, D60, D100, M4, M5, M6, M9 and M12, Analysis of T-cell receptor excision circle (TREC) at baseline (before conditioning), D60, D100, M4, M5, M6,M9 and M12, Imaging of the thymus with MRI at baseline (before conditioning) and M6, Cumulative incidence of infections at D100, M6 and M12, NRM cumulative incidence at D100, M6, M12 and M24, The following endpoints at D100, M6, M12 and M24: Relapse rate (RR); Event free survival (EFS); Disease-free survival (DFS); GvHD-free, relapse-free survival (GRFS); Overall survival (OS)

Source: https://euclinicaltrials.eu/ctis-public/view/2024-517953-28-00